EU clinical trial 2024-519498-20-00: An open-label Phase I/IIa study to evaluate the safety and efficacy of CCS1477 as monotherapy and in combination in patients with advanced haematological malignancies
Protocol code: CCS1477-02
Sponsor: Cellcentric Limited (Pharmaceutical company). Phase: Phase I and Phase II (Integrated)- Other. Countries: Spain (ongoing, recruiting).
Therapeutic area(s): Diseases [C] - Neoplasms [C04]
Gender: Female, Male. Age: 18-64 years, 65+ years. Enrolment: 16.
Status: Ongoing, recruiting. Start date (EU): 2025-05-13. Decision date: 2025-04-29. Results received: No. Last updated: 2026-06-12.

Condition(s): Acute Myeloid Leukaemia (AML)/higher-risk Myelodysplastic Syndrome (MDS), Multiple Myeloma (MM) and Non-Hodgkin Lymphoma (NHL).
Product: POMALIDOMIDE, DEXAMETHASONE, CCS1477-M 10mg, ELRANATAMAB, DEXAMETHASONE, LENALIDOMIDE, DEXAMETHASONE, ELRANATAMAB, TECLISTAMAB, POMALIDOMIDE, LENALIDOMIDE, LENALIDOMIDE, DARATUMUMAB, LENALIDOMIDE, DEXAMETHASONE, POMALIDOMIDE, DARATUMUMAB, POMALIDOMIDE, TECLISTAMAB, LENALIDOMIDE

Primary endpoint: The primary outcome measure for the study is: Safety and tolerability of CCS1477 as monotherapy and in combination., Safety and tolerability will be assessed in terms of AEs, laboratory data, vital signs and ECG changes. These will be collected for all patients. Appropriate summaries of these data will be presented.
Endpoint(s): To characterise the pharmacokinetics (PK) of CCS1477, following a single dose and at steady state after multiple dosing as monotherapy and in combination., To assess preliminary tumour response/activity of CCS1477 in patients with relapsed or refractory haem. malignancies (NHL, MM and AML/higher-risk MDS)., Anti-tumour activity defined by measurement of changes in: - NHL - Radiological assessment, bone marrow disease status and serum immunoglobulins and Tumour biopsy. -MM - Blood/urine samples for myeloma response, bone/bone marrow disease status and serum immunoglobulins. -AML and MDS - Bone marrow disease status., To obtain a preliminary assessment of CCS1477 by evaluation of overall survival (OS).

Source: https://euclinicaltrials.eu/ctis-public/view/2024-519498-20-00